EU clinical trial 2024-516385-10-00: A MULTICENTER, OPEN-LABEL, EVALUATOR-BLINDED, RANDOMIZED STUDY TO EVALUATE THE SAFETY AND TOLERABILITY OF SINGLE-DOSE INTRAVENOUS ORITAVANCIN FOR THE TREATMENT OF PEDIATRIC SUBJECTS WITH ACUTE BACTERIAL SKIN AND SKIN STRUCTURE INFECTIONS
Protocol code: ML-ORI-201
Sponsor: Melinta Therapeutics LLC (Pharmaceutical company). Phase: Therapeutic exploratory (Phase II). Countries: Latvia (ended), Romania (ended), Greece (ended), Portugal (ended), Poland (ended), Spain (ended), Bulgaria (ended), Lithuania (ended).
Therapeutic area(s): Diseases [C] - Skin and Connective Tissue Diseases [C17]
Gender: Female, Male. Age: 0-17 years. Enrolment: 292.
Status: Ended. Start date (EU): 2023-05-02. End date (EU): 2025-11-07. End date: 2025-11-20. Decision date: 2024-11-26. Results received: No. Last updated: 2025-11-25.
Decision dates by country: LT: 2024-11-28, BG: 2024-12-04, RO: 2024-12-02, ES: 2024-11-28, PL: 2024-11-28, GR: 2025-01-09, PT: 2024-11-26, LV: 2024-11-26

Condition(s): Acute Bacterial Skin and Skin Structure Infections
Product: AZACTAM 1 g, poudre et solution pour usage parentéral, Oritavancin, Oritavancin, AZACTAM 1 g, poudre et solution pour usage parentéral

Primary endpoint: Safety assessment of ORBACTIV and KIMYRSA in pediatric populations
Endpoint(s): All-cause mortality assessed at the Time of Cure (ToC) visit

Source: https://euclinicaltrials.eu/ctis-public/view/2024-516385-10-00